EU clinical trial 2022-500244-37-00: A 4-week double-blind, randomized, placebo-controlled, phase II study evaluating the effects of oral pamapimod 150 mg with pioglitazone 10 mg daily on COVID-19 evolution and recovery in non-hospitalized patients infected with SARS-CoV-2 (severe acute respiratory syndrome-coronavirus-2)
Protocol code: KIN001-204
Sponsor: Kinarus AG (Pharmaceutical company). Phase: Therapeutic exploratory (Phase II). Countries: Germany (ended).
Therapeutic area(s): Diseases [C] - Virus Diseases [C02]
Gender: Female, Male. Age: 18-64 years, 65+ years. Enrolment: 150.
Status: Ended. Start date (EU): 2022-08-25. End date (EU): 2025-04-24. Decision date: 2022-08-03. Results received: No. Last updated: 2022-09-20.
Decision dates by country: DE: 2022-09-20

Condition(s): COVID-19
Product: Pioglitazone Placebo, Pamapimod Placebo

Primary endpoint: Number of days alive with no score > 1 in each of the symptoms and a maximum of 3 points in the total score, measured from inclusion to day 28
Endpoint(s): Time to recovery, based on patient-reported daily evaluation of symptoms, All-cause unplanned hospital admission for at least 24 hours or death by day 28, Total sum of daily score of symptoms from inclusion to day 28, Number of days with no symptoms scoring > 1 from inclusion today 14 and day 28, Proportion of patients with full recovery at day 14 and day 28 (no more than 3 items scoring > 1), Inflammatory markers values at day 14 (hsCRP), Safety and tolerability of pamapimod used in combination with pioglitazone (AEs, SAEs), Number of family members (same household) testing positive by rtPCR test within 2 to 10 days after inclusion

Source: https://euclinicaltrials.eu/ctis-public/view/2022-500244-37-00